EU clinical trial 2026-525165-52-00: A Study to Learn How Different Injector Pens Affect the Study Medicine Called Genotropin® (somatropin) Delivery and Taken Up Into the Blood in Healthy Adults
Protocol code: A6281331
Sponsor: Pfizer Inc. (Pharmaceutical company). Phase: Human Pharmacology (Phase I)- Bioequivalence Study. Countries: Belgium (ended).
Therapeutic area(s): Diseases [C] - Hormonal diseases [C19]
Gender: Female, Male. Age: 18-64 years. Enrolment: 26.
Status: Ended. Start date (EU): 2026-04-14. End date (EU): 2026-07-24. End date: 2026-07-25. Decision date: 2026-03-25. Results received: No. Last updated: 2026-03-25.

Condition(s): Growth hormone deficiency

Source: https://euclinicaltrials.eu/ctis-public/view/2026-525165-52-00